EU clinical trial 2025-524335-39-00: A Phase 3, Randomized, Open-label Study to Evaluate the Efficacy and Safety of Switching to Long-acting Antiretroviral Therapy of Broadly Neutralizing Antibodies Teropavimab and Zinlirvimab in Combination With the Capsid Inhibitor Lenacapavir Twice-Yearly Versus Cabotegravir and Rilpivirine Every 8 Weeks in Virologically Suppressed Adults With HIV-1 on Oral Daily Antiretroviral Therapy
Protocol code: GS-US-536-5938
Sponsor: Gilead Sciences Inc. (Pharmaceutical company). Phase: Therapeutic confirmatory (Phase III). Countries: Netherlands (authorised, recruitment pending), Poland (authorised, recruitment pending), Germany (authorised, recruitment pending), France (not authorised), Spain (authorised, recruitment pending), Italy (authorised, recruitment pending).
Therapeutic area(s): Diseases [C] - Virus Diseases [C02]
Gender: Female, Male. Age: 18-64 years, 65+ years. Enrolment: 183.
Decision date: 2026-07-21. Results received: No. Last updated: 2026-07-27.
Decision dates by country: FR: 2026-07-27, DE: 2026-07-24, IT: 2026-07-22, ES: 2026-07-24, NL: 2026-07-21, PL: 2026-07-23

Condition(s): HIV-1
Product: GS-2872, Sunlenca 464 mg solution for injection, GS-5423, Vocabria 400 mg prolonged-release suspension for injection, REKAMBYS 900 mg prolonged-release suspension for injection, Vocabria 600 mg prolonged-release suspension for injection, Sunlenca 300 mg film-coated tablets, REKAMBYS 600 mg prolonged-release suspension for injection

Primary endpoint: Proportion of participants with HIV-1 RNA ≥ 50 copies/mL at Week 52 as defined by the US FDA snapshot algorithm.
Endpoint(s): Proportion of participants with HIV-1 RNA ≥ 50 copies/mL at Week 92 as defined by the US FDA snapshot algorithm., Proportion of participants with HIV-1 RNA < 50 copies/mL at Weeks 52 and 92 as determined by the US FDA snapshot algorithm., Changes from baseline in CD4+ T-cell counts at Weeks 52 and 92., Proportion of participants experiencing TEAEs., Proportion of participants prematurely discontinuing their study treatment due to an AE., Trough concentrations at Weeks 26, 52, and 104 for LEN, TAB, and ZAB., Incidence of ADAs and neutralizing antibodies (NAbs) of TAB and ZAB.

Source: https://euclinicaltrials.eu/ctis-public/view/2025-524335-39-00